EU clinical trial 2025-523305-15-00: THERIPEX - A phase I/II open label non-randomized study, monocentric, single-arm, evaluating Safety and Efficacy of induced T-CD4 Treg by LV vector transduction expressing the FoxP3 cDNA in patients with IPEX syndrom
Protocol code: APHP251137
Sponsor: Assistance Publique Hopitaux De Paris (Hospital/Clinic/Other health care facility). Phase: Human Pharmacology (Phase I)- First administration to humans. Countries: France (authorised, recruitment pending).
Therapeutic area(s): Diseases [C] - Immune System Diseases [C20]
Gender: Male. Age: 0-17 years, 18-64 years. Enrolment: 5.
Status: Authorised, recruitment pending. Decision date: 2026-06-24. Results received: No. Last updated: 2026-06-24.

Condition(s): IPEX syndrome is a primary immunodeficiency caused by hemizygous mutations in the gene FOXP3, which encodes an essential transcription factor required to maintain immunological tolerance by thymus-derived regulatory T (Treg) cells., Patients affected by IPEX syndrome, proven by molecular diagnosis, with any active autoimmune complications or controlled under immunosuppressive therapy can be enrolled in this trial.
Product: FOXP3-T4, ILT-101 liquide

Primary endpoint: The primary endpoint of the study is safety and efficacy up to 24 months following IV infusion of FOXP3-T4 alone or combined with low doses of IL-2 treatment.
Endpoint(s): The efficacy endpoint is assessed until 24 months following the infusion of the FOXP3-T4 treatment alone or combined with low-dose of IL-2 treatment

Source: https://euclinicaltrials.eu/ctis-public/view/2025-523305-15-00